EU clinical trial 2023-506633-30-00: Pharmacokinetic Study of Single and Multiple Dose of PKL-021 Administered Orally to Healthy Subjects
Sponsor: Pikralida Sp. z o.o. (Pharmaceutical company). Phase: Human Pharmacology (Phase I)- Other. Countries: Czechia (ended).
Therapeutic area(s): Diseases [C] - Nervous System Diseases [C10]
Gender: Female, Male. Age: 18-64 years. Enrolment: 12.
Status: Ended. Start date (EU): 2023-10-13. End date (EU): 2023-12-21. Decision date: 2023-10-12. Results received: Yes. Last updated: 2023-11-16.

Condition(s): N/A submitted trial is conducted on healthy subjects
Product: PKL-021, PKL-021, Heparin Léčiva Injekční roztok

Primary endpoint: To determine the pharmacokinetic (PK) profile of single and multiple dose of Test product (T) in healthy adult subjects, To evaluate the effect of food on the PK profile of single dose of Test Product (T) in healthy adult subjects
Endpoint(s): To evaluate the safety and tolerability of Test Product (T) of single and multiple oral dose in healthy subjects.

Source: https://euclinicaltrials.eu/ctis-public/view/2023-506633-30-00